EU clinical trial 2026-525785-22-00: A study to test how well different doses of BI 3822971 are tolerated by people with advanced cancer (solid tumours)
Protocol code: 2015-0001
Sponsor: Boehringer Ingelheim International GmbH, Boehringer Ingelheim Espana S.A. (Pharmaceutical company). Phase: Human Pharmacology (Phase I)- First administration to humans. Countries: Spain (authorised, recruitment pending).
Therapeutic area(s): Diseases [C] - Neoplasms [C04]
Gender: Female, Male. Age: 18-64 years, 65+ years. Enrolment: 39.
Status: Authorised, recruitment pending. Decision date: 2026-07-31. Results received: No. Last updated: 2026-07-31.

Condition(s): solid tumours

Source: https://euclinicaltrials.eu/ctis-public/view/2026-525785-22-00